EU clinical trial 2024-510923-20-00: A Phase 2a Randomized, Double-Blind, Placebo-Controlled Study to Evaluate the Efficacy and Safety of Efinopegdutide (MK-6024) in Adults with Compensated Cirrhosis Secondary to Metabolic Dysfunction-Associated Steatohepatitis
Protocol code: MK-6024-017
Sponsor: Merck Sharp & Dohme LLC (Pharmaceutical company). Phase: Therapeutic exploratory (Phase II). Countries: Spain (ended), France (ended).
Therapeutic area(s): Diseases [C] - Nutritional and Metabolic Diseases [C18]
Gender: Female, Male. Age: 18-64 years, 65+ years. Enrolment: 24.
Status: Ended. Start date (EU): 2024-09-16. End date (EU): 2026-08-03. End date: 2026-08-04. Decision date: 2024-08-05. Results received: No. Last updated: 2026-02-27.
Decision dates by country: ES: 2024-08-05, FR: 2024-08-08

Condition(s): Metabolic Dysfunction-Associated Steatohepatitis
Product: efinopegdutide, efinopegdutide, efinopegdutide, Placebo to MK-6024, efinopegdutide

Primary endpoint: Change from baseline in liver fat content (LFC) at week 28, Percentage of participants who experienced an adverse event (AE), Percentage of participants discontinuing study medication due to an AE
Endpoint(s): Change from baseline in iron-corrected T1 (cT1) at week 28, Change from baseline in enhanced liver fibrosis (ELF) score at week 28, Change from baseline in propeptide of type III collagen (Pro-C3) at week 28, Change from baseline in fibrosis-4 index (FIB-4) at week 28, Change from baseline in liver stiffness measurement (LSM) assessed by vibration-controlled transient elastography (VCTE) at week 28, Percent change from baseline in body weight at week 28

Source: https://euclinicaltrials.eu/ctis-public/view/2024-510923-20-00